EU clinical trial 2024-514594-21-00: Two part (double-blind inclisiran versus placebo [Year 1] followed by open-label inclisiran [Year 2]]) randomized multicenter study to evaluate safety, tolerability and efficacy of inclisiran in children (6 to less than 12 years) with heterozygous familial hypercholesterolemia and elevated LDL-cholesterol (ORION-20)
Protocol code: CKJX839C12303
Sponsor: Novartis Pharma AG (Pharmaceutical company). Phase: Therapeutic confirmatory (Phase III). Countries: Czechia (ongoing, recruitment ended), Portugal (ongoing, recruiting), Netherlands (ongoing, recruiting), France (ongoing, recruiting), Belgium (ongoing, recruiting), Greece (ongoing, recruiting), Spain (ongoing, recruiting), Poland (ongoing, recruitment ended), Germany (ongoing, recruiting), Hungary (ongoing, recruiting), Austria (ongoing, recruiting), Italy (ongoing, recruiting).
Therapeutic area(s): Diseases [C] - Cardiovascular Diseases [C14]
Gender: Female, Male. Age: 0-17 years. Enrolment: 43.
Start date (EU): 2025-03-13. Decision date: 2025-02-04. Results received: No. Last updated: 2026-07-31.
Decision dates by country: AT: 2025-02-10, BE: 2025-02-05, CZ: 2025-02-05, FR: 2025-02-07, DE: 2025-02-05, GR: 2025-02-04, HU: 2025-02-07, IT: 2025-03-24, PT: 2025-02-04, ES: 2025-02-05, NL: 2025-02-07, PL: 2025-02-10

Condition(s): Heterozygous Familial Hypercholesterolemia
Product: INCLISIRAN, Placebo to KJX839 (Inclisiran) 0 mg/1.5 mL Solution for injection in vial, KJX839

Primary endpoint: Percentage change in LDL-C from baseline to Day 330 (Year 1)
Endpoint(s): Time-adjusted percent change in LDL-C from baseline after Day 90 and up to Day 330 (Year 1), Absolute change in LDL-C from baseline to Day 330 (Year 1), Percent change in PCSK9, total cholesterol, Apo B, and non-HDL-C from baseline to Day 330 (Year 1), Percent change and absolute change in LDL-C, PCSK9, total cholesterol, Apo B, non-HDL-C, lipoprotein (a) [Lp(a)], triglycerides, high density lipoprotein cholesterol (HDL-C), very low density lipoprotein cholesterol (VLDL-C), and apolipoprotein A1 (Apo A1) from baseline to each assessment time up to Day 720 (Year 2), Incidence, severity and relationship to study drug of treatment-emergent adverse events (AEs) and serious adverse events (SAEs); vital signs; laboratory parameters; anti-drug antibodies (ADA) measurement; growth (height, weight, body mass index (BMI)); pubertal development (sexual hormones and Tanner staging)

Source: https://euclinicaltrials.eu/ctis-public/view/2024-514594-21-00